EU clinical trial 2023-504111-33-00: A Phase 2 Open-label Randomized Study of Farletuzumab Ecteribulin (MORAb-202), a Folate Receptor Alpha-targeting Antibody-Drug Conjugate, vs Investigator's Choice Chemotherapy in Women with Platinum-resistant High-grade Serous (HGS) Ovarian, Primary Peritoneal, or Fallopian Tube Cancer
Protocol code: CA116-001
Sponsor: Bristol Myers Squibb International Corporation (Pharmaceutical company). Phase: Therapeutic exploratory (Phase II). Countries: Belgium (ended), Italy (ended), Spain (ended).
Therapeutic area(s): Diseases [C] - Neoplasms [C04]
Gender: Female. Age: 18-64 years, 65+ years. Enrolment: 55.
Status: Ended. Start date (EU): 2023-02-14. End date (EU): 2025-09-10. End date: 2025-09-11. Decision date: 2024-04-16. Results received: No. Last updated: 2025-09-08.
Decision dates by country: ES: 2024-04-16, BE: 2024-04-18, IT: 2024-05-06

Condition(s): Platinum-resistant High-grade Serous Ovarian, Primary Peritoneal, or Fallopian Tube Cancer
Product: Caelyx pegylated liposomal 2 mg/ml concentrate for solution for infusion, PACLITAXEL, TOPOTECAN, farletuzumab ecteribulin

Primary endpoint: 1. Objective response rate (ORR) by Response Evaluation Criteria in Solid Tumors (RECIST) v1.1 per Investigator assessment, 2. Occurence of TRAEs leading to discontinuation.
Endpoint(s): 1. Occurrence of the AEs/SAEs, treatment-related AEs/SAEs, AEs leading to discontinuation, AESIs, deaths and laboratory abnormalities, 2. DoR by RECIST v1.1 per investigator Assessment among responders, 3. PFS by RECIST v1.1 per Investigator Assessment

Source: https://euclinicaltrials.eu/ctis-public/view/2023-504111-33-00